EU clinical trial 2025-521982-29-00: UNLOCK - EPIBREAST, a phase II study of prifetrastat (PF-07248144), a KAT6 inhibitor, plus fulvestrant for advanced HR+/HER2- breast cancer with biomarkers analysis
Protocol code: UC-GMP-2504
Sponsor: Unicancer (Hospital/Clinic/Other health care facility). Phase: Therapeutic exploratory (Phase II). Countries: France (authorised, recruitment pending).
Therapeutic area(s): Diseases [C] - Neoplasms [C04]
Gender: Female, Male. Age: 18-64 years, 65+ years. Enrolment: 51.
Status: Authorised, recruitment pending. Decision date: 2026-05-22. Results received: No. Last updated: 2026-05-22.

Condition(s): Adult patients with advanced hormone receptor positive (HR+), HER2- breast cancer after at least a first line of endocrine therapy combined with CDK4/6 inhibitor in the metastatic setting
Product: PF-07248144, FULVESTRANT ZENTIVA 250 mg, solution injectable en seringue préremplie, PF-07248144

Primary endpoint: A Guardant Health (Guardant360®) assay will be used for ctDNA detection and sequencing and evaluation of tumor mutation burden defined by the mean change in Variant Allele Frequency (VAF) of 74 prespecified genes, from cycle 1 to cycle 3. Primary endpoint will be evaluated per cohort (as defined in section “Therapeutic regimen” below) and in the overall population.
Endpoint(s): Mechanism of action of prifetrastat will be evaluated per cohort and in the overall population: -Assessment of ER/PR/Ki67,HER2 and H3K23ac staining with IHC,at baseline,on treatment and at progression.-Dynamics of genomic alterations interest through Whole Exome Sequencing (WES) at baseline at progression and RNA-Sequencing at baseline, on treatment at progression. -Epigenetics change through ATAC-Seq, at baseline,on treatment, at progression.-Molecular changes at genomics and transcriptomics, Trough Cconcentration of prifetrastat, Anti-tumor activity endpoints will be evaluated per cohort and the overall population by the objective response rate (ORR) on investigator assessment, defined as the percentage of patients with at least a confirmed (per RECIST v1.1) complete response (CR) or partial response (PR), based on the best objective response values., Anti-tumor activity endpoints will be evaluated per cohort and the overall population by - Progression Free Survival (PFS) is defined as the time from first day of treatment until disease progression (per RECIST v1.1) or death from any cause, whichever occurs first, by investigator assessment. At the time of analysis, a patient alive and without disease progression will be censored at the date of the last valid tumor assessment, Anti-tumor activity endpoints will be evaluated per cohort and the overall population by - Duration of Response (DoR) will be evaluated in patients with either a complete response (CR) or partial response (PR). DoR is defined as the time from the first assessment of a confirmed CR or PR until the date of the first occurrence of progressive disease (PD) or death from any cause (if death occurred within predefined period), whichever occurs first, by investigator assessment., Anti-tumor activity endpoints will be evaluated per cohort and the overall population by Clinical Benefit Rate (CBR) is defined as the percentage of patients with a confirmed complete response (CR) or partial response (PR) or stable disease (SD) for more than 24 weeks from first day of treatment assessed according to RECIST 1.1 criteria, by investigator assessment., The safety will be evaluated according to the incidence of adverse events (AEs) graded by NCI-CTCAE v5.0 (Appendix 6).

Source: https://euclinicaltrials.eu/ctis-public/view/2025-521982-29-00